EU clinical trial 2023-508153-12-00: Dexamethasone for treating severe hospital-acquired pneumonia in critically ill patients with a proinflammatory phenotype, an international phase III, double-blind, placebo-controlled, randomized trial - the HAP-DEX study
Protocol code: RC23_0358
Sponsor: Centre Hospitalier Universitaire De Nantes (Hospital/Clinic/Other health care facility). Phase: Therapeutic confirmatory (Phase III). Countries: France (ongoing, recruiting), Belgium (ended), Greece (ongoing, recruitment ended), Spain (ongoing, recruiting).
Therapeutic area(s): Diseases [C] - Bacterial Infections and Mycoses [C01]
Gender: Female, Male. Age: 18-64 years, 65+ years. Enrolment: 476.
Start date (EU): 2024-03-26. Decision date: 2024-01-29. Results received: No. Last updated: 2026-07-06.
Decision dates by country: BE: 2025-06-23, FR: 2024-01-29, ES: 2025-07-21, GR: 2025-07-24

Condition(s): Hospital-acquired pneumonia
Product: DEXAMETHASONE PHOSPHATE, SODIUM CHLORIDE

Primary endpoint: The co-primary hierarchic endpoints to demonstrate the efficacy of dexamethasone plus SOC compared to placebo plus SOC for the treatment of hospital-acquired pneumonia will be a clinical cure at the test-of-cure (TOC) visit and all-cause mortality at Day 28.
Endpoint(s): In case of a non-significant difference in the rate of clinical cure, the co-primary outcome (all-cause mortality at Day 28) will be presented as a secondary outcome., All-cause mortality at Month 3 and Month 6., Rate of pleural empyema at Day 28., Rate of microbiological failure (defined as a positive respiratory culture at the ToC visit)., Rate of pneumonia relapse (defined as a second episode of HAP with one or more identical pathogens), rate of pneumonia recurrence (defined as a second episode of HAP with different pathogens) at Day 28., Time course of body temperature, cardiac pulse rate, oxygen saturation, PaO2/FiO2, type of mechanical ventilation support (invasive, noninvasive, none) (daily evaluation at 8.00 am and 8.00 pm), and leukocyte counts (every 48 hours) for 10 days., Rates of non-respiratory hospital-acquired infection at day 28: urinary tract infection, surgical site infection, invasive candidiasis, septicemia., Antibiotic-free days at Day 28 (the number of antibiotic-free days is defined as the number of days between Day 1 and Day 28 for which living patients do not receive antibiotics. Dead patients will be ascribed 0 antibiotic-free days)., Duration of invasive mechanical ventilation and invasive mechanical ventilation-free days at Month 6 (defined as the number of days between Day 1 and Month 6 for which living patients breathe spontaneously. Dead patients will be ascribed 0 mechanical ventilation-free days)., Duration of hospitalization and hospital-free days at Month 6 (the number of hospital-free days is defined as the number of days between Day 1 and Month 6 for which living patients are outside of a hospital. Dead patients will be ascribed 0 hospital-free days)., Rate of serious adverse reactions and suspected unexpected serious adverse reaction (SUSAR) at Day 28., Rate of metabolic adverse events during the 5-7-day treatment period (number of days with a blood level of potassium < 3.5 mmol/l, number of days with of sodium < 135 mmol/l, daily dose of insulin)., Rate of gastric ulcer., Economic endpoints at 6 months: Incremental cost-effectiveness ratio (ICER), Changes in health-related quality of life (HRQoL) from three (M3) to six months (M6) after randomization measured with the Short Form (SF)-36 scale validated in French, Changes in anxiety and depression from M3 to M6 were measured with the HADS scale validated in French, Changes in subjective well-being from M3 to M6 measured with the Satisfaction With Life Scale (SWLS) validated in French, Rates of major cardiovascular events at Day 28: subsegmental pulmonary embolism, stroke, myocardial infarction (positive ST segment).

Source: https://euclinicaltrials.eu/ctis-public/view/2023-508153-12-00